EU clinical trial 2024-516804-40-00: Long-Term Low-Intervention SafEty and Clinical Outcomes Clinical Study of LivmArli® in Patients with Alagille Syndrome or Progressive Familial Intrahepatic Cholestasis in the European Union (LEAP-EU)
Protocol code: MRX-803
Sponsor: Mirum Pharmaceuticals Inc. (Pharmaceutical company). Phase: Therapeutic use (Phase IV). Countries: Spain (ongoing, recruiting), France (ongoing, recruiting), Italy (ongoing, recruiting), Belgium (ongoing, recruiting), Germany (ongoing, recruiting), Netherlands (ongoing, recruiting), Portugal (authorised, recruitment pending).
Therapeutic area(s): Diseases [C] - Digestive System Diseases [C06]; Diseases [C] - Congenital, Hereditary, and Neonatal Diseases and Abnormalities [C16]; Diseases [C] - Cardiovascular Diseases [C14]
Gender: Female, Male. Age: 0-17 years, 18-64 years, 65+ years. Enrolment: 231.
Start date (EU): 2025-09-25. Decision date: 2025-04-21. Results received: No. Last updated: 2026-07-31.
Decision dates by country: FR: 2025-04-22, BE: 2025-11-18, DE: 2025-12-15, NL: 2025-12-15, IT: 2025-04-22, ES: 2025-04-21, PT: 2026-07-31

Condition(s): Alagille syndrome, Progressive Familial Intrahepatic Cholestasis
Product: Livmarli 9.5 mg/mL oral solution

Primary endpoint: Safety • AEs • The number and proportion of participants who experience an AE • Change in liver function tests from Baseline • Change in FSV levels and INR (as an estimate of vitamin K) from Baseline • For participants with PFIC PG toxicity will be monitored, Efficacy • Change in pruritus severity from Baseline as measured by Clinician Scratch Scale (CSS) score • Change in serum bile acids (sBA) levels from Baseline • Frequency in the use of concomitant medications for the treatment of underlying liver disease, treatment of pruritus, or treatment of cholestasis • Frequency and timing of long-term clinical outcomes, Tolerability: Tolerability of starting dose and dose escalation will be assessed by summarizing AEs and/or any other safety information (as available) on starting dose and during dose escalation phase. The cases of dose reduction, treatment interruption, and treatment discontinuation due to AEs/poor tolerability will be also summarized over the whole treatment period., Growth: Growth, including height/length and weight, will be assessed as an endpoint. The endpoint will be assessed as change from Baseline in height/length and weight (absolute values and z-scores)., Overdose, Dosing Errors, Misuse, and Abuse Frequencies of overdose and dosing errors/medication errors will be calculated.

Source: https://euclinicaltrials.eu/ctis-public/view/2024-516804-40-00